EU clinical trial 2022-502335-19-00: A Phase 3, Open-Label, Single-arm, Multicenter Study to Evaluate the Pharmacokinetics, Pharmacodynamics, Activity, and Safety of Ravulizumab Administered Subcutaneously in Pediatric Participants (2 to < 18 years of age) with Paroxysmal Nocturnal Hemoglobinuria (PNH) or Atypical Hemolytic Uremic Syndrome (aHUS)
Protocol code: ALXN1210-PED-316
Sponsor: Alexion Pharmaceuticals Inc. (Pharmaceutical company). Phase: Therapeutic confirmatory (Phase III). Countries: Italy (ended), Spain (ended).
Therapeutic area(s): Diseases [C] - Immune System Diseases [C20]
Gender: Female, Male. Age: 0-17 years, 18-64 years. Enrolment: 14.
Status: Ended. End date (EU): 2023-11-08. Decision date: 2023-08-02. Results received: No. Last updated: 2023-08-07.
Decision dates by country: IT: 2023-08-07, ES: 2023-08-02

Condition(s): Treatment of Paroxysmal Nocturnal Hemoglobinuria (PNH) or Atypical Hemolytic Uremic Syndrome (aHUS)
Product: Ravulizumab, Ultomiris 300 mg/3 mL concentrate for solution for infusion, Ravulizumab

Primary endpoint: Summary statistics of ravulizumab concentrations at Day 1 postdose, Day 15 predose, Day 15 postdose, and Day 71 predose Summary statistics of serum free C5 concentrations at Day 1 postdose, Day 15 predose, Day 15 postdose, and Day 71 predose
Endpoint(s): PK and PD (Both Cohorts) Serum ravulizumab concentrations over time through Week 52 Absolute values, change from baseline, and percentage change from baseline for free serum C5 concentrations over time through Week 52, Efficacy (PNH Cohort Only) Percentage change from baseline in LDH to Week 10 and Week 52 Incidence of BTH through Week 10 and Week 52 Achievement of transfusion avoidance through Week 10 and Week 52 Achievement of stabilized hemoglobin through Week 10 and Week 52 Change from baseline in PNH RBC clone size at Week 52, Efficacy (aHUS Cohort Only) Dialysis requirement status through Week 10 and Week 52 Observed value and change from baseline in eGFR through Week 10 and Week 52 Observed value and change from baseline in serum creatinine through Week 10 and Week 52 Observed value and change from baseline in hematologic parameters through Week 10 and Week 52: • Platelets • LDH • Hemoglobin, Health-related QoL (Both Cohorts) Change from baseline in patient-reported fatigue, as measured by Pediatric FACIT-Fatigue (participants ≥ 8 years of age) to Week 10 and Week 52 Change from baseline in PedsQL 4.0 Generic Core Scale to Week 10 and Week 52, Safety (Both Cohorts) Incidence of AEs and SAEs Incidence of ADEs and serious ADEs in participants treated with ravulizumab SC via OBI, Device Performance (Both Cohorts) Reported outcome of attempted full-dose administration via OBI Reported device deficiencies/complaints and associated device investigations, Immunogenicity (Both Cohorts) ADA incidence, response categories and titer in study participants treated with ravulizumab SC for the duration of the study

Source: https://euclinicaltrials.eu/ctis-public/view/2022-502335-19-00